EU clinical trial 2024-512904-21-00: A Phase 2, Randomised, Multicentre, Parallel-Group Treatment, Double-Blind Study to Investigate the Safety and Efficacy of Subcutaneous MEDI0618 in the Reduction of Migraine Headache Days Compared to Placebo in Adult Participants with Episodic Migraine
Protocol code: D7060C00003(M26-031)
Sponsor: AbbVie Deutschland GmbH & Co. KG (Pharmaceutical company). Phase: Therapeutic exploratory (Phase II). Countries: Czechia (ongoing, recruiting), Poland (ongoing, recruiting), Netherlands (ended), Italy (ongoing, recruiting), Hungary (ongoing, recruiting), Spain (ongoing, recruiting), Germany (ongoing, recruiting), Denmark (ongoing, recruiting).
Therapeutic area(s): Diseases [C] - Nervous System Diseases [C10]
Gender: Female, Male. Age: 18-64 years, 65+ years. Enrolment: 477.
Start date (EU): 2025-12-10. Decision date: 2024-11-19. Results received: No. Last updated: 2026-07-27.
Decision dates by country: DK: 2024-11-19, DE: 2024-11-22, NL: 2024-11-21, CZ: 2024-11-20, HU: 2024-11-22, IT: 2024-11-21, ES: 2024-11-21, PL: 2024-11-24

Condition(s): Migraine
Product: MEDI0618, Placebo to match MEDI0618

Primary endpoint: Change in number of MHDs from 4-week baseline to last 4 weeks of treatment period (Week 9 to Week 12)

Source: https://euclinicaltrials.eu/ctis-public/view/2024-512904-21-00